EU clinical trial 2024-516739-29-00: P2-IMU-838-MS - Randomized, double-blind, placebo-controlled, multicenter Phase 2 trial assessing the effect of IMU-838 on disease activity, as measured by magnetic resonance imaging (MRI), as well as safety and tolerability in patients with relapsingremitting multiple sclerosis (RRMS) (EMPhASIS)
Protocol code: P2-IMU-838-MS
Sponsor: Immunic AG (Pharmaceutical company). Phase: Therapeutic exploratory (Phase II). Countries: Germany (authorised, recruiting), Bulgaria (authorised, recruiting), Romania (authorised, recruiting), Poland (authorised, recruiting).
Therapeutic area(s): Diseases [C] - Nervous System Diseases [C10]
Gender: Female, Male. Age: 18-64 years. Enrolment: 142.
Status: Authorised, recruiting. Start date (EU): 2019-01-23. Decision date: 2024-09-11. Results received: No. Last updated: 2026-07-31.
Decision dates by country: RO: 2024-09-16, DE: 2024-09-12, PL: 2024-09-16, BG: 2024-09-11

Condition(s): Relapsing-remitting multiple sclerosis
Product: IMU-838 22.5 mg tablet, IMU-838 15 mg tablets, IMU-838 30 mg tablet, Placebo for IMU-838 Tablets

Primary endpoint: Efficacy Cohort 1 (C1): Difference between 45 mg/day IMU-838 and placebo in the cumulative number of combined unique active (CUA) MRI lesions up to Week 24 Cohort 2 (C2): Between-treatment differences in the cumulative number of CUA MRI and Gd+ lesions up to Week 24
Endpoint(s): Key secondary (hierarchical testing to primary efficacy) Efficacy C1: Difference between 30 mg/day IMU-838 and placebo in the cumulative number of CUA MRI lesions up to Week 24, Efficacy: C1: Difference between 45 mg/day IMU-838 and 30 mg/day IMU-838 in the cumulative number of CUA MRI lesions at Week 24, Efficacy: C1: Difference between 30 mg/day IMU-838 and placebo, 45 mg/day IMU-838 and placebo, and 30 mg/day and 45 mg/day IMU-838, C1: Differences between individual treatments and between the pooled 30 mg/day and 45 mg/day groups and placebo in the following relapserelated clinical endpoints: Mean annualized relapse rate (during main and extended treatment period); Proportion of relapse-free patients up to Week 24 and at extended periods thereafter; Time to relapse at time of final analysis of main part, C2: Number of relapses in each treatment arm, C1: Differences between treatments in changes of disease activity as measured by the following clinical parameters: Mean change in the EDSS as compared to Baseline during the main and extended period (every 12 weeks starting at Week 12); Proportion of patients with EDSS progression during the main and extended period (every 12 weeks starting at Week 12, and cumulatively), C2: Change of EDSS from Baseline to Weeks 12 and 24 C1: Correlation of MRI-based assessments with quartiles of IMU-838 trough levels at Week 6 and Week 24 C2: Correlation of MRI-based assessments with quartiles of IMU-838 trough levels at Week 24, Safety C1+C2: AEs, serious AEs and clinically significant laboratory abnormalities (as assessed by the investigator), C1+C2: AEs of special interest: Red blood cell urine positive, at least of moderate intensity; Hematuria; Retroperitoneal colicky pain with suspected or confirmed nephrolithiasis, C1: Proportion of patients treated with 30 mg/day or 45 mg/day IMU 838 as compared to placebo who experienced at least one of the following AEs, C2: Proportion of patients treated with 10 mg/day as compared to placebo who experienced at least one of the following AEs:Neutropenia; Lymphopenia; Diarrhea; Alopecia; Hemorrhage; Abnormalities in alanine aminotransferase, aspartate aminotransferase, gamma glutamyl transferase, and total bilirubin with both elevations ˃1.5 x ULN and ≥35% elevated compared to Baseline, ECG, physical examination, and vital signs, C1: Micro ribonucleic acid-122 expression (Change from Baseline to 4 hours after first dose), C1: Presence of John Cunningham virus (JCV) deoxyribonucleic acid (DNA) in urine in patients with detectable JCV-DNA in urine at Screening Visit 1, at Week 24, and at EoS, C1+C2: Time to treatment discontinuation for any reason, C1+C2: Rate of treatment discontinuations up to Week 24, Pharmacokinetics C1+C2: Population PK at Week 6 (3-10 hours post-dose) C1+C2: Plasma trough levels of IMU-838 at Days 7 and Weeks 6, 12, 18, and 24, Pharmacodynamics C1: Changes from Baseline in lymphocyte subset parameters as measured by flow cytometry at Weeks 6 and 24 (in selected Biomarker Centers only), C1: Changes from Baseline in biased T-cell clonal repertoire based on T-cell receptor deep sequencing at Weeks 6 and 24 (in selected Biomarker Centers only), C1+C2: Changes from Baseline in serum neurofilament at Week 24 C2: Changes in serum C4 (7α-hydroxy-4-cholesten-3-one) C2: Changes in serum fibroblast growth factor 19 (FGF-19), Health outcome (C1) Treatment Satisfaction Questionnaire for Medication at Week 6, Week 24 and EoS

Source: https://euclinicaltrials.eu/ctis-public/view/2024-516739-29-00